EU clinical trial 2022-501494-39-00: THINK - intensification of blood pressure lowering Therapeutics based on diuretics versus usual management for uncontrolled Hypertension IN patients with moderate to severe chronic Kidney disease: an open label, cluster randomized controlled, phase 3 trial
Protocol code: DR210320
Sponsor: Centre Hospitalier Regional Universitaire De Tours (Hospital/Clinic/Other health care facility). Phase: Therapeutic confirmatory (Phase III). Countries: France (ongoing, recruiting).
Therapeutic area(s): Diseases [C] - Cardiovascular Diseases [C14]; Diseases [C] - Male Urogenital Diseases [C12]
Gender: Female, Male. Age: 18-64 years, 65+ years. Enrolment: 720.
Status: Ongoing, recruiting. Start date (EU): 2023-03-28. Decision date: 2023-01-23. Results received: No. Last updated: 2026-03-03.

Condition(s): Uncontrolled Hypertension IN patients with moderate to severe chronic Kidney disease
Product: INDAPAMIDE, INDAPAMIDE, HYDROCHLOROTHIAZIDE, FUROSEMIDE, AMILORIDE HYDROCHLORIDE

Primary endpoint: Time to event outcome, considering the following composite endpoint: end stage kidney disease (need for kidney replacement therapy or renal transplantation), eGFR decline ≥40% (CKD-EPI formula), cardiovascular events (myocardial infarction, heart failure hospitalization, stroke), all cause mortality
Endpoint(s): Time to end-stage kidney disease, Time to eGFR decrease ≥40%, Time to the first cardiovascular event (myocardial infarction, heart failure hospitalization, stroke), All cause mortality, Change from baseline systolic and diastolic blood pressure at months 3 and 6 then every 6 months (home blood pressure monitoring and office blood pressure measurement), Proportion of patients with controlled blood pressure at 2 years (PA< 135 and/or 85mmHg with home blood pressure monitoring), Change from baseline in glomerular filtration rate estimated by CKD-EPI formula at months 3 and 6 then every 6 months, Change from baseline in proteinuria (g/d) or proteinuria /creatininuria (g/g) at months 3 and 6 then every 6 months, Proportion of patients who used at least one diuretic, Change from baseline in quality of life assessed by PROMIS-29 survey each year, Safety: volume depletion, dyskalemia, hyponatremia, acute kidney injury, gout, orthostatic hypotension symptomatic/asymptomatic or complicated by falls

Source: https://euclinicaltrials.eu/ctis-public/view/2022-501494-39-00